EU clinical trial 2024-514860-14-00: Cell-mediated skipping of exon 51 for the genetic correction of dystrophin, based upon a single injection of autologous mesoangioblasts (MABs) in individual skeletal muscles of five non-ambulant patients affected by Duchenne Muscular Dystrophy: a non randomized, open-label, phase I/IIa study
Sponsor: Ospedale San Raffaele S.r.l., University Of Manchester (Hospital/Clinic/Other health care facility, Educational Institution). Phase: Phase I and Phase II (Integrated)- First administration to humans. Countries: Italy (ongoing, recruitment ended).
Therapeutic area(s): Diseases [C] - Musculoskeletal Diseases [C05]
Gender: Male. Age: 0-17 years. Enrolment: 5.
Status: Ongoing, recruitment ended. Start date (EU): 2024-06-27. Decision date: 2024-10-01. Results received: No. Last updated: 2024-12-20.

Condition(s): Duchenne Muscular Dystrophy
Product: DMD06-MAB

Primary endpoint: Safety 1. Incidence and severity of local (foot) and systemic adverse events (any grade) in DMD patients treated with intra- muscular injections of genetically corrected auto-MABS for one year from the injection., Efficacy 2.Presence of dystrophin (≥ to 1:10 dilution of a control muscle for WB; ≥ 10% of gene expression of skipped dystrophin at ddPCR; ≥ 10% of dystrophin positive fibers for IF respect to a control muscle) on muscle biopsy of the EDB muscle transplanted with genetically corrected auto-MABS, in at least two out of the three assays (Quantitative IF , ddPCR, and Western Blot) at two months after injection.

Source: https://euclinicaltrials.eu/ctis-public/view/2024-514860-14-00